EU clinical trial 2023-510093-13-00: NeoAdjuvant PErsonalized therapy in Estrogen Receptor positive breast cancer (NAPEER) - An open label phase II trial of endocrine treatment with or without capivasertib, followed by response assessment before neoadjuvant chemotherapy with bevacizumab (if ViRP signature positive).
Protocol code: ESR-20-20871
Sponsor: Oslo University Hospital HF (Hospital/Clinic/Other health care facility). Phase: Therapeutic exploratory (Phase II). Countries: Norway (ongoing, recruiting).
Therapeutic area(s): Diseases [C] - Pathological Conditions, Signs and Symptoms [C23]
Gender: Female, Male. Age: 18-64 years, 65+ years. Enrolment: 150.
Status: Ongoing, recruiting. Start date (EU): 2022-05-11. Decision date: 2024-09-05. Results received: No. Last updated: 2025-11-25.

Condition(s): Patients with hormone receptor positive HER2 negative breast cancer.
Product: Avastin 25 mg/ml concentrate for solution for infusion., TRUQAP 160 mg film-coated tablets, Avastin 25 mg/ml concentrate for solution for infusion., TRUQAP 200 mg film-coated tablets

Primary endpoint: Treatment efficacy will for the primary end-point in chemotherapy part of the study be evaluated after the end of chemotherapy treatment.
Endpoint(s): Treatment efficacy for the primary endpoint in endocrine therapy part of the study will be evaluated by the use of Ki67 staining and quantification in the thru-cut biopsy specimen obtained at the time of the response evaluation after 15 days of therapy (+/- 3 days).

Source: https://euclinicaltrials.eu/ctis-public/view/2023-510093-13-00